EU clinical trial 2024-511544-36-00: An Open-Label, Randomized, Controlled, Phase 2 Study to Evaluate the Safety and Efficacy of Pegcetacoplan in the Treatment of Post-Transplant Recurrence of C3G or IC‑MPGN
Protocol code: APL2-C3G-204
Sponsor: Apellis Pharmaceuticals Inc. (Pharmaceutical company). Phase: Therapeutic exploratory (Phase II). Countries: Netherlands (ended), Austria (ended), Italy (ended).
Therapeutic area(s): Diseases [C] - Immune System Diseases [C20]
Gender: Female, Male. Age: 18-64 years, 65+ years. Enrolment: 7.
Status: Ended. Start date (EU): 2021-12-21. End date (EU): 2025-11-24. End date: 2026-01-20. Decision date: 2024-11-13. Results received: No. Last updated: 2026-02-25.
Decision dates by country: AT: 2024-11-18, NL: 2024-11-13, IT: 2024-11-26

Condition(s): complement 3 glomerulopathy (C3G)/immune complex membranoproliferative glomerulonephritis (IC-MPGN)
Product: ASPAVELI 1 080 mg solution for infusion

Primary endpoint: The primary efficacy endpoint is the proportion of subjects with reduction in C3c staining on renal biopsy after 12 weeks of treatment with pegcetacoplan.
Endpoint(s): The proportion of subjects with reduction in C3c staining on renal biopsy after 52 weeks of treatment, The proportion of subjects with stabilization or improvement in estimated glomerular filtration rate (eGFR), over time, The proportion of subjects with stabilization or improvement of serum creatinine concentration over time, Changes from baseline biopsy in C3c staining over time, Changes and percentage changes from baseline in eGFR and serum creatinine concentration over time, Safety: The number and incidence of treatment-emergent adverse events (TEAEs), Safety: The change from baseline in vital signs measurements and clinical laboratory test and ECG results

Source: https://euclinicaltrials.eu/ctis-public/view/2024-511544-36-00